EU clinical trial 2023-505062-28-00: A Phase 1b/2, dose expansion, open-label study to evaluate safety and anti-tumor activity of intravesical instillation of TARA-002 in adults with high-grade non-muscle invasive bladder cancer.
Protocol code: TARA-002-101-Ph1b/2
Sponsor: Protara Therapeutics Inc. (Pharmaceutical company). Phase: Phase I and Phase II (Integrated)- Other. Countries: Spain (not authorised), Romania (not authorised).
Therapeutic area(s): Diseases [C] - Neoplasms [C04]
Gender: Female, Male. Age: 18-64 years, 65+ years. Enrolment: 35.
Status: Not authorised. Decision date: 2023-09-11. Results received: No. Last updated: 2023-09-18.
Decision dates by country: RO: 2023-09-18, ES: 2023-09-11

Condition(s): Non-muscle invasive bladder cancer
Product: TARA-002

Primary endpoint: Cohort A: • Incidence of high-grade CR at any time, Cohort A: • Incidence of high-grade CR at any time by subgroup (BCG naïve and BCG exposed > 24 months), Cohort B • Incidence of high-grade CR at any time
Endpoint(s): Cohort A: • Incidence and severity of AEs, Cohort A:• Incidence and severity of TEAEs, Cohort A:• Incidence and severity of SAEs, Cohort A:• Incidence and severity of TESAEs, Cohort A:• Cytokine urine levels pre-treatment, during treatment and post-treatment, Cohort A:• QoL as assessed by the EORTC: QLQ-C30 and QLQ-NMIBC24, Cohort B: • Duration of high-grade CR, Cohort B: • High-grade CR rate at Months 3, 6, 9, 12, 15, 18, 21, and 24, Cohort B: • Duration of CR (all recurrent bladder cancer, including low grade Ta), Cohort B: • CR rate (all recurrent bladder cancer, including low grade Ta) at Months 3, 6, 9, 12, 15, 18, 21, and 24, Cohort B: • Progression Free Survival (PFS), Cohort B: • Disease-specific Progression Free Survival (DSPFS), Cohort B: • Overall Survival (OS), Cohort B: • Disease-specific Survival (DSS), Cohort B: • Time to Cystectomy, Cohort B: • Time to Recurrence Delayed Cystectomy, Cohort B: • Time to Progression, Cohort B: • Time to Disease Worsening, Cohort B: • Incidence and severity of AEs, Cohort B: • Incidence and severity of TEAEs, Cohort B: • Incidence and severity of SAEs, Cohort B: • Incidence and severity of TESAEs, Cohort B: • Cytokine urine levels pre-treatment, during treatment and post-treatment, Cohort B: • QoL as assessed by the EORTC: QLQ-C30 and QLQ-NMIBC24

Source: https://euclinicaltrials.eu/ctis-public/view/2023-505062-28-00